EU clinical trial 2023-507091-47-00: A Phase 1, Open-Label, Multicenter Study of INCB161734 in Participants With Advanced or Metastatic Solid Tumors with KRAS G12D Mutation
Protocol code: INCB 161734-101
Sponsor: Incyte Corp. (Pharmaceutical company). Phase: Human Pharmacology (Phase I)- First administration to humans. Countries: Italy (temporarily halted), France (temporarily halted), Belgium (temporarily halted), Spain (temporarily halted).
Therapeutic area(s): Diseases [C] - Neoplasms [C04]
Gender: Female, Male. Age: 18-64 years, 65+ years. Enrolment: 260.
Status: Temporarily halted. Start date (EU): 2025-02-10. Decision date: 2024-10-14. Results received: No. Last updated: 2026-06-26.
Decision dates by country: FR: 2024-10-17, BE: 2024-10-15, IT: 2024-10-15, ES: 2024-10-14

Condition(s): Advanced or metastatic solid tumors

Source: https://euclinicaltrials.eu/ctis-public/view/2023-507091-47-00